EU clinical trial 2024-513802-77-00: Efficacy and Tolerance of Baricitinib, a JAK Inhibitor, in the Treatment of Refractory Non-infectious Non-anterior Uveitis (JAKUVEITE)
Protocol code: 2020/420/HP
Sponsor: Centre Hospitalier Universitaire Rouen (Hospital/Clinic/Other health care facility). Phase: Therapeutic confirmatory (Phase III). Countries: France (ended).
Therapeutic area(s): Diseases [C] - Eye Diseases [C11]
Gender: Female, Male. Age: 18-64 years. Enrolment: 33.
Status: Ended. Start date (EU): 2023-08-30. End date (EU): 2024-12-26. Decision date: 2024-05-28. Results received: No. Last updated: 2024-05-28.

Condition(s): Active non-anterior non-infectious uveitis
Product: Olumiant 4 mg film-coated tablets, Olumiant 2 mg film-coated tablets, CORTANCYL 5 mg, comprimé sécable, FLUOCYNE 10%, solution injectable I.V., FLUORESCEINE SODIQUE FAURE 10 POUR CENT, solution injectable

Primary endpoint: Partial remission at 6 months. In case of bilateral involvement, the eye with the most severe involvement will be the eye chosen for the study.
Endpoint(s): Partial remission at 1 month, 3 months of treatment, according to the same parameters as defined for the primary endpoint., Median change in visual acuity (LogMAR) at 1 month, 3 months and 6 months of treatment compared to baseline ophthalmologic assessment, Slit-lamp measurement of median change in anterior chamber inflammation according to the Tyndall, SUN (1) scale at 1 month, 3 months and 6 months of treatment compared to baseline ophthalmologic assessment, Slit-lamp measurement of median change in vitreous inflammation according to the vitreous haze (SUN [1]) at 1 month, 3 months, and 6 months of treatment compared with the initial ophthalmologic evaluation., Fluorescein angiographic analysis of vasculitis lesions at 1 month, 3 months, and 6 months of treatment compared with the initial ophthalmologic evaluation, Optical coherence tomography measurement of median change in central macular thickness at 1 month, 3 months, and 6 months of treatment compared with the initial ophthalmologic evaluation., Measurement of the number of patients with correction of cystoid macular edema measured by optical coherence tomography (cystoid macular thickness <300 μm and disappearance of intraretinal logettes) at 1 month, 3 months, and 6 months of treatment compared with the initial ophthalmologic assessment, Measurement of median change in corticosteroid dosages at 1 month, 3 months, and 6 months of treatment compared with the initial ophthalmologic evaluation, EvI and EvIG on baricitinib from initiation of treatment through 6 months of follow-up.

Source: https://euclinicaltrials.eu/ctis-public/view/2024-513802-77-00